EU clinical trial 2024-513379-41-00: Study of DFF332 alone and in combination with Everolimus or Immuno-oncology therapies in patients with renal cell carcinoma and other selected tumors.
Protocol code: CDFF332A12101
Sponsor: Novartis Pharma AG (Pharmaceutical company). Phase: Human Pharmacology (Phase I)- First administration to humans. Countries: Czechia (ended), Spain (ended), France (ended).
Therapeutic area(s): Diseases [C] - Neoplasms [C04]
Gender: Female, Male. Age: 18-64 years, 65+ years. Enrolment: 28.
Status: Ended. Start date (EU): 2021-01-26. End date (EU): 2024-11-25. End date: 2026-02-13. Decision date: 2024-06-11. Results received: No. Last updated: 2024-12-04.
Decision dates by country: FR: 2024-06-17, CZ: 2024-06-13, ES: 2024-06-11

Condition(s): Advanced, relapsed Clear Cell Renal Cell Carcinoma

Source: https://euclinicaltrials.eu/ctis-public/view/2024-513379-41-00